EU clinical trial 2023-506631-15-00: A multicentre, randomised, double-blind, placebo-controlled phase III study, evaluating the effect of dapagliflozin on prevention of cardiotoxicity in breast cancer patients undergoing anthracycline-based chemotherapy (PROTECTAA).
Protocol code: 2022/ABM/01/00039
Sponsor: 4 Wojskowy Szpital Kliniczny Z Polikliniką Samodzielny Publiczny Zaklad Opieki Zdrowotnej We Wroclawiu (Hospital/Clinic/Other health care facility). Phase: Therapeutic confirmatory (Phase III). Countries: Poland (ongoing, recruitment ended).
Therapeutic area(s): Diseases [C] - Neoplasms [C04]; Diseases [C] - Cardiovascular Diseases [C14]
Gender: Female, Male. Age: 18-64 years, 65+ years. Enrolment: 188.
Status: Ongoing, recruitment ended. Start date (EU): 2024-04-15. Decision date: 2023-11-30. Results received: No. Last updated: 2025-09-12.

Condition(s): Patients with invasive breast cancer, on stage I-III, and planned anthracycline treatment within 60 days.
Product: Forxiga 10 mg film-coated tablets, PLACEBO to FORXIGA 10mg (Microcrystalline cellulose 102 (2,5mg), Magnesium stearate (247,5mg)

Primary endpoint: Primary efficacy composite endpoint (cancer therapeutics related cardiac dysfunction, CTRCD):, the appearance of heart failure symptoms (NYHA class I-IV) due to an impairment of heart function or structure within 12 months; or, asymptomatic decrease in left ventricular ejection fraction > 10% after 12 months; or, asymptomatic decrease in left ventricular ejection fraction < 10% but up to 40-49% after 12 months; or, asymptomatic decrease in global left ventricular longitudinal strain >15% after 12 months; or, asymptomatic increase in biomarkers (troponin I > upper reference limit (99th centile) and increase of at least 30% from pre-treatment concentration or NTproBNP > 125 pg/ml and increase of at least 30% from baseline) after 12 months.
Endpoint(s): Secondary Composite Efficacy Endpoint:, 1. emergence of heart failure symptoms (NYHA class I-IV) due to impaired cardiac function or structure at 6 months; or, 2. decrease LVEF > 10% after 6 months; or, 3. decrease LVEF < 10% but to a value of 40-49% after 6 months; or, 4. a decrease in global longitudinal strain of > 15% after 6 months; or, 5. asymptomatic increase in biomarkers (troponin I > upper reference limit (99th centile) and an increase of at least 30% from pre-treatment concentration or NTproBNP > 125pg/ml and an increase of at least 30% from baseline) after 6 months., Secondary Additional Endpoints:, 1. change in left ventricular ejection fraction at 6 and 12 months;, 2. change in left ventricular diastolic function, assessed as the ratio of E/E', i.e. maximum mitral annular inflow velocity during the rapid ventricular filling phase, to maximum mitral annular motion velocity by tissue Doppler during the rapid ventricular filling phase;, 3. change in Troponin I after 6 and 12 months;, 4. change in NTproBNP levels at 6 and 12 months;, 5. change in quality of life assessment at 6 and 12 months., Secondary Endpoints (Safety):, 1. death from any cause;, 2. composite endpoint of cardiovascular events (death from cardiovascular causes, non-fatal myocardial infarction, non-fatal stroke);, 3. death from any cardiovascular reasons;, 4. non-fatal myocardial infarction;, 5. non-fatal stroke;, 6. occurrence of hypoglycaemia;, 7. occurrence of ionic disorders;, 8. progression of renal failure;, 9. hypersensitivity to investigated drug;, 10. allergic reactions;, 11. infection., 12. any other AEs, evaluated due to type, frequency and severity.

Source: https://euclinicaltrials.eu/ctis-public/view/2023-506631-15-00